EU clinical trial 2023-508365-33-00: HELIOS-A: A Phase 3 Global, Randomized, Open-label Study to Evaluate the Efficacy and Safety of ALN-TTRSC02 in Patients With Hereditary Transthyretin Amyloidosis (hATTR Amyloidosis)
Protocol code: ALN-TTRSC02-002
Sponsor: Alnylam Pharmaceuticals Inc. (Pharmaceutical company). Phase: Therapeutic confirmatory (Phase III). Countries: Netherlands (ended), Belgium (ended), Cyprus (ended), Spain (ended), Portugal (ended), Bulgaria (ended), Italy (ended).
Therapeutic area(s): Diseases [C] - Congenital, Hereditary, and Neonatal Diseases and Abnormalities [C16]
Gender: Female, Male. Age: 18-64 years, 65+ years. Enrolment: 44.
Status: Ended. Start date (EU): 2019-04-09. End date (EU): 2025-07-17. End date: 2025-11-05. Decision date: 2024-06-12. Results received: No. Last updated: 2025-02-25.
Decision dates by country: BE: 2024-06-13, BG: 2024-06-28, CY: 2024-06-17, IT: 2024-06-24, PT: 2024-06-14, ES: 2024-06-17, NL: 2024-06-12

Condition(s): Hereditary Transthyretin Amyloidosis
Product: Amvuttra 25 mg solution for injection in pre-filled syringe, Onpattro 2 mg/mL concentrate for solution for infusion.

Primary endpoint: Change from baseline in the Modified Neurologic Impairment Score +7 (mNIS+7) of the ALN-TTRSC02 group compared to the placebo arm of the Phase 3 patisiran-LNP study (ALN-TTR02-004; APOLLO)
Endpoint(s): Change from baseline in the following parameters of the ALN-TTRSC02 group compared to the placebo arm of the APOLLO (patisiran) study: - Norfolk Quality of Life-Diabetic Neuropathy (Norfolk QoL-DN) total score - Timed 10-meter walk test (10-MWT) - mNIS+7 - Modified body mass index (mBMI) - Rasch-built Overall Disability Scale (R-ODS), Percent reduction in serum TTR levels in the ALN-TTRSC02 arm compared to the within-study patisiran arm

Source: https://euclinicaltrials.eu/ctis-public/view/2023-508365-33-00